EU clinical trial 2023-509399-40-00: AN OPEN-LABEL, RANDOMIZED, SINGLE DOSE, TWO-STAGE CROSSOVER ADAPTIVE BIOEQUIVALENCE STUDY OF TRIAMCINOLONE ACETONIDE 40 MG/ML STERILE INJECTABLE SUSPENSION (Test product–Lisapharma S.p.A) VERSUS KENACORT® 40 MG/ML SUSPENSION (Reference product – Bristol Myers Squibb) AFTER INTRAMUSCULAR ADMINISTRATION TO HEALTHY VOLUNTEERS
Sponsor: Laboratorio Italiano Biochimico Farmaceutico Lisapharma S.p.A. (Pharmaceutical company). Phase: Human Pharmacology (Phase I)- Bioequivalence Study. Countries: Italy (ended).
Therapeutic area(s): Diseases [C] - Skin and Connective Tissue Diseases [C17]
Gender: Female, Male. Age: 18-64 years. Enrolment: 30.
Status: Ended. Start date (EU): 2024-05-09. End date (EU): 2025-03-27. Decision date: 2024-04-04. Results received: No. Last updated: 2024-04-04.

Condition(s): Intramuscular administration of triamcinolone acetonide Lisapharma (Injectable suspension of triamcinolone acetonide) is indicated for systemic corticosteroid therapy in morbid conditions such as allergic syndrome (to control severe or debilitating conditions not treatable in a conventional way), dermatoses, generalized rheumatoid arthritis and other connective tissue diseases.

Source: https://euclinicaltrials.eu/ctis-public/view/2023-509399-40-00